EU clinical trial 2024-519723-20-01: uPAR PET/MRI in glioma
Protocol code: 2016-002417-21
Sponsor: Rigshospitalet (Hospital/Clinic/Other health care facility). Phase: Phase I and Phase II (Integrated)- Other. Countries: Denmark (authorised, recruitment pending).
Therapeutic area(s): Diseases [C] - Nervous System Diseases [C10]; Analytical, Diagnostic and Therapeutic Techniques and Equipment [E] - Diagnosis [E01]; Diseases [C] - Neoplasms [C04]
Gender: Female, Male. Age: 18-64 years, 65+ years. Enrolment: 61.
Status: Authorised, recruitment pending. Decision date: 2025-01-29. Results received: No. Last updated: 2025-01-29.

Condition(s): Glioma
Product: [68Ga]NOTA-AE105

Primary endpoint: Standard uptake values (SUVs) of 68Ga-NOTA-AE105 evaluated on uPAR-PET/MRI scan performed within 1 hour following injection of 68Ga-NOTA-AE105, compared with immunohistochemistry of uPAR (semiquantitative)
Endpoint(s): The prognostic significance of uPAR expression, as assessed by uPAR-PET/MRI, will be evaluated for its correlation with overall and progression free survival. Patients will be followed for a total of 36 months post uPAR-PET/MRI

Source: https://euclinicaltrials.eu/ctis-public/view/2024-519723-20-01